EU clinical trial 2024-518389-28-00: Impact of an Angiotensin Receptor Blocker in Aortic Stenosis (ARBAS) – A Randomized Controlled Trial
Protocol code: ARBAS041218
Sponsor: Odense University Hospital (Hospital/Clinic/Other health care facility). Phase: Therapeutic use (Phase IV). Countries: Denmark (ongoing, recruiting).
Therapeutic area(s): Diseases [C] - Cardiovascular Diseases [C14]
Gender: Female, Male. Age: 18-64 years, 65+ years. Enrolment: 139.
Status: Ongoing, recruiting. Start date (EU): 2025-01-30. Decision date: 2025-01-30. Results received: No. Last updated: 2026-04-10.

Condition(s): Aortic stenosis
Product: LOSARTAN POTASSIUM, PLACEBO

Primary endpoint: The rate of progression of peak aortic velocity (m/s) assessed by echocardiography, The rate of progression of aortic valve calcification (AU) assessed by non-contrast computed tomography after 24 months treatment with losartan compared with placebo.
Endpoint(s): Left ventricular geometry and mass (relative wall-thickness, left ventricular mass index) assessed by echocardiography and magnetic resonance imaging after 24 months treatment with losartan compared with placebo treatment., Diastolic function assessed by echocardiography, Markers of left ventricular filling pressures (E/e’, NT-proBNP)

Source: https://euclinicaltrials.eu/ctis-public/view/2024-518389-28-00